EU clinical trial 2024-520305-39-00: Efficacy and safety of minidosing lysergic acid diethylamide (LSD) for chronic cluster headache: a randomized placebo-controlled study
Sponsor: Radboud universitair medisch centrum Stichting (Hospital/Clinic/Other health care facility). Phase: Therapeutic exploratory (Phase II). Countries: Netherlands (ongoing, recruiting).
Therapeutic area(s): Diseases [C] - Nervous System Diseases [C10]
Gender: Female, Male. Age: 0-17 years, 18-64 years, 65+ years. Enrolment: 52.
Status: Ongoing, recruiting. Start date (EU): 2025-04-01. Decision date: 2025-01-21. Results received: No. Last updated: 2026-03-23.

Condition(s): Chronic cluster headache
Product: Lysergide D-tartrate, Placebo for Lysergide tartrate oral solution

Primary endpoint: Mean change in weekly attack frequency in the third treatment week compared to the 4-week baseline, across treatment groups.

Source: https://euclinicaltrials.eu/ctis-public/view/2024-520305-39-00